EU clinical trial 2024-510581-17-00: (ASK-CHF2-CS201) A Phase 2, adaptive, double-blinded, placebo-controlled, randomized, multi-center trial to evaluate the efficacy, safety and tolerability of intracoronary infusion of AB-1002 in adult subjects with New York Heart Association (NYHA) Class III heart failure and non-ischemic cardiomyopathy
Protocol code: ASK-CHF2-CS201
Sponsor: Askbio Inc. (Pharmaceutical company). Phase: Therapeutic exploratory (Phase II). Countries: Austria (ongoing, recruitment ended), Spain (ongoing, recruitment ended), Germany (ongoing, recruitment ended), Netherlands (ongoing, recruitment ended), Hungary (ongoing, recruitment ended), Belgium (ongoing, recruitment ended), Bulgaria (ongoing, recruitment ended), Romania (ongoing, recruitment ended), Poland (ongoing, recruitment ended).
Therapeutic area(s): Diseases [C] - Cardiovascular Diseases [C14]
Gender: Female, Male. Age: 18-64 years, 65+ years. Enrolment: 243.
Status: Ongoing, recruitment ended. Start date (EU): 2024-11-05. Decision date: 2024-09-10. Results received: No. Last updated: 2026-07-17.
Decision dates by country: HU: 2024-12-11, BG: 2025-08-21, RO: 2025-08-25, PL: 2025-08-22, DE: 2024-09-27, NL: 2024-09-16, ES: 2024-09-10, BE: 2025-08-08, AT: 2024-09-15

Condition(s): Adult subjects with New York Heart Association (NYHA) Class III congestive heart failure and non-ischemic cardiomyopathy
Product: AB-1002, AB-1002 Placebo

Primary endpoint: Modified Win Ratio at 52-weeks as defined by hierarchical evaluation of the following assessments in the given order: - Cardiovascular related death (Binary) - NYHA Classification change from baseline (Ordinal) - LVEF change from baseline (Binary, >=5% increase for responders) - six-minute walk test (6MWT) change from baseline (Binary >30m increase for responders), The safety endpoints will be assessed over the 52-week Observation Period as indicated in the Schedule of Activities: - Treatment-Emergent Adverse Events (AEs) and Serious Adverse Events (SAEs) - Observed value and change from baseline in clinical laboratory tests - Observed value and change from baseline in vital signs - Observed value and change from baseline in electrocardiograms (ECGs)
Endpoint(s): Cardiovascular related death, Functional Status and Hospitalizations at 24 and 52 weeks, Observed value and change from baseline in NYHA Classification, Observed value and change from baseline in LVEF, Observed value and change from baseline in 6MWT, Number of HF hospitalizations, Time to first HF hospitalization, Physiologic Assessments, Observed value and change from baseline in Echocardiographic assessments of: - LVEF (at 4, 12 and 36 weeks) - LV volumes: end systolic and end diastolic volumes - LVEDV and left ventricular end diastolic index (LVEDVI) - LVESV and LVESVI - sphericity index (SpI) - GLS and - degree of mitral regurgitation, Observed value and change from baseline in cardiac biomarker NT-proBNP, Observed value and change from baseline in the KCCQ as assessed by a 15-item, self-administered instrument that quantifies physical function, symptoms (frequency, severity, and recent change), social function, self-efficacy and knowledge, and QOL

Source: https://euclinicaltrials.eu/ctis-public/view/2024-510581-17-00